EU clinical trial 2023-509197-35-00: A Phase 3, Randomized, Double-Masked, Placebo-Controlled, Multicenter Study to Evaluate the Efficacy, Safety, Tolerability, Pharmacokinetics, Pharmacodynamics, and Immunogenicity of Efgartigimod PH20 SC Administered by Prefilled Syringe in Adult Participants With Thyroid Eye Disease
Protocol code: ARGX-113-2301
Sponsor: Argenx (Pharmaceutical company). Phase: Therapeutic confirmatory (Phase III). Countries: Estonia (ended), Czechia (ended), Germany (ended), Spain (ended), Greece (ended), Hungary (ended), Bulgaria (ended), Belgium (ended), Romania (ended), Italy (ended).
Therapeutic area(s): Diseases [C] - Eye Diseases [C11]
Gender: Female, Male. Age: 18-64 years, 65+ years. Enrolment: 64.
Status: Ended. Start date (EU): 2024-10-17. End date (EU): 2025-12-15. Decision date: 2024-09-23. Results received: No. Last updated: 2025-12-10.
Decision dates by country: DE: 2024-09-27, EE: 2024-09-23, ES: 2024-09-25, CZ: 2024-09-25, HU: 2024-09-30, BE: 2024-09-23, GR: 2024-09-23, IT: 2024-09-27, BG: 2024-09-30, RO: 2024-09-30

Condition(s): Thyroid Eye Disease (TED)
Product: Efgartigimod, Placebo for efgartigimod

Primary endpoint: Percentage of participants who were proptosis responders at week 24 of the Double-Blind treatment period (DBTP).
Endpoint(s): Change in proptosis measurement in the study eye from baseline to week 24 of the Double-Blind Treatment Period (DBTP), Change in the total GO-QoL score from baseline to week 24 of the Double-Blind Treatment Period (DBTP), Percentage of participants with a resolution of diplopia (responders) a at week 24 of the Double-Blind Treatment Period (DBTP).

Source: https://euclinicaltrials.eu/ctis-public/view/2023-509197-35-00